EU clinical trial 2024-518535-11-00: A Study to Understand What the Body Does to the Study Medicine Called PF-07976016 When Taken by Healthy Adults
Protocol code: C5541002
Sponsor: Pfizer Inc. (Pharmaceutical company). Phase: Human Pharmacology (Phase I)- Other. Countries: Netherlands (ended).
Therapeutic area(s): Diseases [C] - Nutritional and Metabolic Diseases [C18]
Gender: Male. Age: 18-64 years, 65+ years. Enrolment: 8.
Status: Ended. Start date (EU): 2025-05-30. End date (EU): 2025-08-14. End date: 2025-08-15. Decision date: 2025-05-26. Results received: No. Last updated: 2025-05-26.

Condition(s): Obesity, Overweight

Source: https://euclinicaltrials.eu/ctis-public/view/2024-518535-11-00